EU clinical trial 2025-524553-13-00: Low-dose versus standard-dose anticoagulation with argatroban or enoxaparin during extracorporeal membrane oxygenation controlled by anti-IIa or anti-Xa assay
Sponsor: Fakultni Nemocnice Ostrava (Hospital/Clinic/Other health care facility). Phase: Therapeutic exploratory (Phase II). Countries: Czechia (authorised, recruitment pending).
Therapeutic area(s): Diseases [C] - Cardiovascular Diseases [C14]; Diseases [C] - Respiratory Tract Diseases [C08]
Gender: Female, Male. Age: 18-64 years, 65+ years. Enrolment: 200.
Status: Authorised, recruitment pending. Decision date: 2026-03-19. Results received: No. Last updated: 2026-03-19.

Condition(s): lung and/or heart failure
Product: Argatra Multidose 100 mg/ml Konzentrat zur Herstellung einer Infusionslösung, CLEXANE 10 000 IU (100 mg)/1 ml injekční roztok v předplněné injekční stříkačce

Primary endpoint: To comprehensively compare the efficacy and safety of anticoagulation therapy in patients on ECMO support with argatroban, enoxaparin and in the combined population of patients with argatroban or enoxaparin
Endpoint(s): To determine the relationship between argatroban concentration and the incidence of bleeding and thrombotic complications and the consumption of blood derivatives and transfusion products, To determine the relationship between the dose or concentration of anticoagulant and laboratory parameters for monitoring anticoagulation, To determine the relationship between laboratory parameters and bleeding and thrombotic complications

Source: https://euclinicaltrials.eu/ctis-public/view/2025-524553-13-00